EU clinical trial 2024-511850-34-00: A Phase I/II Study of Paclitaxel plus Carboplatin and Durvalumab (MEDI4736) with or without Oleclumab (MEDI9447) for Previously Untreated Locally Recurrent Inoperable or Metastatic Triple-Negative Breast Cancer
Protocol code: IJB-SYNERGY-012017
Sponsor: Institut Jules Bordet (Hospital/Clinic/Other health care facility). Phase: Phase I and Phase II (Integrated)- Other. Countries: Belgium (ongoing, recruitment ended), France (ongoing, recruitment ended).
Therapeutic area(s): Diseases [C] - Neoplasms [C04]
Gender: Female. Age: 18-64 years. Enrolment: 209.
Status: Ongoing, recruitment ended. Start date (EU): 2019-01-02. Decision date: 2024-06-06. Results received: No. Last updated: 2026-02-16.
Decision dates by country: BE: 2024-06-06, FR: 2024-06-12

Condition(s): Previously untreated locally recurrent inoperable or metastatic triple-negative breast cancer (TNBC)
Product: PACLITAXEL, Durvalumab_IJB, CARBOPLATIN, Oleclumab_IJB

Primary endpoint: PHASE I: Safety and tolerability will be assessed by monitoring frequency, duration and severity of adverse events (AEs). PHASE II: Clinical benefit (CB). CB is defined as a patient who achieved CR or PR or demonstrated SD at 24 weeks from the 1st dose of study drug administration based on RECIST v1.1
Endpoint(s): PHASE I: Safety and tolerability will be assessed by monitoring frequency, duration and severity of adverse events (AEs) including Dose limiting toxicities (DLTs) as defined per protocol, PHASE II: 1) Objective Response. OR is defined as a patient (in the intent-to treat population) who achieved a CR or PR as best overall response (BOR) based on RECIST v1.1., 2) Duration of Response. DOR is defined as the time from documentation of first tumour response to disease progression based on RECIST v1.1., 3) Progression Free Survival. PFS is defined as the time from 1st study drug administration to the first documented disease progression based on RECIST v1.1 or death due to any cause, whichever occurs first. (Subjects who are alive and progression free at the time of analysis will be censored at the time-point of their last tumour assessment by imaging.), 4) Overall Survival. OS is defined as the time from 1st study drug administration to death due to any cause. (Subject without documented death at the time of the analysis will be censored at the date of the last follow-up.), 5) Frequency, duration and severity of AEs assessment based on CTCAE 5.0

Source: https://euclinicaltrials.eu/ctis-public/view/2024-511850-34-00